EU clinical trial 2023-508287-30-00: A MULTICENTER, OPEN-LABEL, OUTPATIENT STUDY TO EVALUATE THE SAFE AND EFFECTIVE USE OF A ZILUCOPLAN AUTO INJECTOR COMBINATION PRODUCT FOR SUBCUTANEOUS SELF-ADMINISTRATION BY STUDY PARTICIPANTS WITH GENERALIZED MYASTHENIA GRAVIS
Protocol code: DV0013
Sponsor: UCB Biopharma (Pharmaceutical company). Phase: Therapeutic confirmatory (Phase III). Countries: Poland (ended).
Therapeutic area(s): Diseases [C] - Immune System Diseases [C20]
Gender: Female, Male. Age: 18-64 years, 65+ years. Enrolment: 6.
Status: Ended. Start date (EU): 2024-08-29. End date (EU): 2024-09-30. End date: 2025-02-03. Decision date: 2024-07-15. Results received: Yes. Last updated: 2024-07-15.

Condition(s): Generalized Myasthenia Gravis
Product: Zilucoplan sodium

Primary endpoint: Effective self administrations of zilucoplan using the zilucoplan-auto-injector (ZLP-AI) from Visit 1 to Visit 8.
Endpoint(s): - Effective self administration of zilucoplan using ZLP-AI at Visit 8 - Effective self administration of zilucoplan using ZLP-AI at Visit 1 - Occurrence of serious adverse events (SAEs) during the course of the study - Occurrence of treatment-emergent adverse events (TEAEs) during the course of the study - Occurrence of nonserious adverse device effects (ADE) during the course of the study - Occurrence of serious adverse device effects (SADE) during the course of the study

Source: https://euclinicaltrials.eu/ctis-public/view/2023-508287-30-00